EU clinical trial 2023-506829-11-00: A trial comparing the effect and safety of once weekly dosing of somapacitan with daily Norditropin® in children with growth hormone deficiency
Protocol code: NN8640-4263
Sponsor: Novo Nordisk A/S (Pharmaceutical company). Phase: Therapeutic confirmatory (Phase III). Countries: Germany (ended), Italy (ended), Spain (ended), Slovenia (ended), Poland (ended), Austria (ended), France (ended), Latvia (ended).
Therapeutic area(s): Diseases [C] - Hormonal diseases [C19]
Gender: Female, Male. Age: 0-17 years. Enrolment: 22.
Status: Ended. Start date (EU): 2019-05-29. End date (EU): 2025-09-30. End date: 2025-10-01. Decision date: 2024-06-11. Results received: Yes. Last updated: 2025-10-31.
Decision dates by country: AT: 2024-06-17, FR: 2024-07-19, DE: 2024-06-17, IT: 2024-06-17, LV: 2024-06-21, SI: 2024-06-11, ES: 2024-06-17, PL: 2024-06-13

Condition(s): Growth Hormone Deficiency in children
Product: Sogroya 15 mg/1.5 mL solution for injection in pre-filled pen, Sogroya 5 mg/1.5 mL solution for injection in pre-filled pen, Sogroya 10 mg/1.5 mL solution for injection in pre-filled pen, Norditropin FlexPro, injektionsvæske, opløsning i fyldt pen

Primary endpoint: Endpoint title: Height velocity Time frame: From baseline (week 0) to visit 7 (week 52) Unit: cm/year
Endpoint(s): Effect Endpoint title: Change in bone age Time frame: From screening (visit 1) to visit 7 (week 52) Unit: Years, Effect Endpoint title: Change in Height Standard Deviation Score Time frame: From baseline (week 0) to visit 7 (week 52) Unit: -10 to +10, Effect Endpoint title: Change in Height Velocity SDS Time frame: From baseline (week 0) to visit 7 (week 52) Unit: -10 to +10, Safety Endpoint title: Change in fasting plasma glucose Time frame: From screening (visit 1) to visit 7 (week 52) From screening (visit 1) to visit 11 (week 104) From screening (visit 1) to visit 15 (week 156) From screening (visit 1) to visit 19 (week 208) Unit: mmol/L, Safety Endpoint title: Change in homeostatic model assessment (HOMA) Time frame: From screening (visit 1) to visit 7 (week 52) From screening (visit 1) to visit 11 (week 104) From screening (visit 1) to visit 15 (week 156) From screening (visit 1) to visit 19 (week 208) Unit: %, Safety Endpoint title: Change in Glycated haemoglobin (HbA1c) Time frame: From screening (visit 1) to visit 7 (week 52) From screening (visit 1) to visit 11 (week 104) From screening (visit 1) to visit 15 (week 156) From screening (visit 1) to visit 19 (week 208) Unit: % point, Pharmacodynamics Endpoint title: Change in IGF-I SDS Time frame: From baseline (week 0) to visit 7 (week 52) From baseline (week 0) to visit 11 (week 104) From baseline (week 0) to visit 15 (week 156) From baseline (week 0) to visit 19 (week 208) Unit: -10 to +10, Pharmacodynamics Endpoint title: Change in IGFBP-3 SDS Time frame: From baseline (week 0) to visit 7 (week 52) From baseline (week 0) to visit 11 (week 104) From baseline (week 0) to visit 15 (week 156) From baseline (week 0) to visit 19 (week 208) Unit: -10 to +10

Source: https://euclinicaltrials.eu/ctis-public/view/2023-506829-11-00